EU clinical trial 2024-516369-36-00: A Phase 1 Study of HMPL-306 in Advanced Hematological Malignancies with Isocitrate Dehydrogenase (IDH) Mutations
Protocol code: 2020-306-GLOB1
Sponsor: Hutchmed Ltd. (Pharmaceutical company). Phase: Human Pharmacology (Phase I)- Other. Countries: Spain (ended).
Therapeutic area(s): Diseases [C] - Neoplasms [C04]
Gender: Female, Male. Age: 18-64 years, 65+ years. Enrolment: 37.
Status: Ended. Start date (EU): 2021-02-09. End date (EU): 2025-01-15. End date: 2025-01-16. Decision date: 2024-08-21. Results received: No. Last updated: 2024-08-21.

Condition(s): - Acute myeloid leukemia; - Myelodysplastic syndrome/ Myeloproliferative neoplasm; - Angio-immunoblastic T-cell lymphoma; - Other mIDH-positive hematological malignancies (other than tumor types mentioned above)

Source: https://euclinicaltrials.eu/ctis-public/view/2024-516369-36-00